EU clinical trial 2023-507090-18-00: Analgesic efficacy of wound infiltration vs ultrasound-guided transversus abdominis plane block in laparoscopic colorectal surgery
Protocol code: TAP-IN
Sponsor: Hospital Universitario La Paz (Hospital/Clinic/Other health care facility). Phase: Therapeutic use (Phase IV). Countries: Spain (ongoing, recruiting).
Therapeutic area(s): Analytical, Diagnostic and Therapeutic Techniques and Equipment [E] - Anesthesia and Analgesia [E03]
Gender: Female, Male. Age: 18-64 years, 65+ years. Enrolment: 60.
Status: Ongoing, recruiting. Start date (EU): 2024-01-16. Decision date: 2023-10-30. Results received: No. Last updated: 2023-10-30.

Condition(s): Patients scheduled for laparoscopic colorectal surgery
Product: Levobupivacaína Kabi 2,5 mg/ml solución inyectable y para perfusión EFG

Primary endpoint: Difference between total opioid consumption of TAP group versus Wound Infiltration (WI) group 48h. after surgery.
Endpoint(s): Difference between total opioid consumption of TAP group versus Wound Infiltration (WI) group at post-anesthesia recovery unit (PACU) and 24h after surgery., Difference between pain score at rest and movement (by VAS or NRS) of TAP group versus Wound Infiltration (WI) group at post-anesthesia recovery unit (PACU), 24h. and 48h. after surgery., Difference between the incidence of nausea and vomiting of TAP group versus Wound Infiltration (WI) group at post-anesthesia recovery unit (PACU), 24h. and 48h. after surgery., Difference between the onset of oral tolerance, ambulation movilization and length of hospital stay of TAP group versus Wound Infiltration (WI) group.

Source: https://euclinicaltrials.eu/ctis-public/view/2023-507090-18-00